EU clinical trial 2023-505802-40-02: Clinical study of the anesthetic efficacy of 2% lidocaine gel versus tetracaine/oxybuprocaine anesthetic eye drops in patients operated on for glaucoma and undergoing needing techniques in outpatient surgery
Sponsor: Hospital Universitario De Torrevieja (Hospital/Clinic/Other health care facility). Phase: Therapeutic use (Phase IV). Countries: Spain (authorised, recruiting).
Therapeutic area(s): Diseases [C] - Eye Diseases [C11]
Gender: Female, Male. Age: 18-64 years, 65+ years. Enrolment: 60.
Status: Authorised, recruiting. Start date (EU): 2024-10-09. Decision date: 2024-02-19. Results received: No. Last updated: 2024-02-19.

Condition(s): glaucoma
Product: Ophtesic 20 mg/g, gel oftálmico en envase unidosis, COLIROFTA ANESTÉSICO DOBLE 1 MG/ML + 4 MG/ML COLIRIO EN SOLUCIÓN

Primary endpoint: Assessment of pain manifested by patients by numerical rating scale (NRS) from 0 to 10 /Average time spent on the procedure in both anesthetic treatment groups
Endpoint(s): Percentage of patients requiring re-anaesthesia in both treatment groups, Surgeon comfort/degree of patient cooperation: numerical rating scale (NRS) from 0 to 10., Percentage of patients requiring oral analgesia, Assessment of the visualization of the surgical field using a numerical scale from 0 to 5, with 5 being the best possible visualization

Source: https://euclinicaltrials.eu/ctis-public/view/2023-505802-40-02